EU clinical trial 2024-511467-28-00: HYSTINDO_Study of the vascularization of the vaginal slice after total laparoscopic hysterectomy, using indocyanine green injection. Prospective feasibility study
Protocol code: AOI 2023 CHAUVET
Sponsor: University Hospital Of Clermont-Ferrand (Hospital/Clinic/Other health care facility). Phase: Therapeutic use (Phase IV). Countries: France (ongoing, recruiting).
Therapeutic area(s): Diseases [C] - Female Urogenital Diseases and Pregnancy Complications [C13]; Analytical, Diagnostic and Therapeutic Techniques and Equipment [E] - Diagnosis [E01]
Gender: Female. Age: 18-64 years, 65+ years. Enrolment: 90.
Status: Ongoing, recruiting. Start date (EU): 2024-09-20. Decision date: 2024-07-19. Results received: No. Last updated: 2025-09-04.

Condition(s): total hysterectomy
Product: INFRACYANINE 25 mg/10 mL, poudre et solvant pour solution injectable

Primary endpoint: Evolution of green levels in an area of interest, from which a time-fluorescence curve can be obtained. The presence of fluorescence will be defined by the fluorescence intensity value Fmax-Fmin.
Endpoint(s): The different parameters from the perfusion curve: minimum fluorescence intensity Fmin, fluorescence intensity Fmax, the difference in fluorescence intensity Fmax-min, the slope of the fluorescence intensity, the time ratio TR, Objective measurements of fluorescence and the surgeon's assessment (Likert scale), From the injection of indocyanine green during the procedure until the post-operative consultation, the side effects and the occurrence of adverse events linked to the injection of indocyanine green will be noted, The time added by the protocol to the total operating time. The duration of the phase corresponding to the protocol will be equal to the time between the injection of indocyanine green and the stopping of video recording in minutes. The total operating time will be equal to the time between the incision time and the closing time in minutes, The vascularization of the vaginal slice defined by a fluorescence intensity value Fmax-Fmin on the graph according to patient characteristics, The vascularization of the vaginal slice defined by a fluorescence intensity value Fmax-Fmin on the graph according to surgical technique (coagulation tool and method, type of energy, type of suture, type of thread)., The vascularization of the vaginal slice defined by a fluorescence intensity value Fmax-Fmin on the graph according to the type of camera (SPIES, RUBINA and FIREFLY systems)., The vascularization of the vaginal slice defined by a fluorescence intensity value Fmax-Fmin on the graph according to post-operative complications (bleeding, fever, biological inflammatory syndrome, pain, early post-operative abscess, hemoperitoneum, hematoma, infection/abscess, fistula)., The vascularization of the vaginal slice defined by a fluorescence intensity value Fmax-Fmin on the graph according to the condition of the vaginal fundus scar

Source: https://euclinicaltrials.eu/ctis-public/view/2024-511467-28-00